EU clinical trial 2024-517839-50-00: Adjunctive DobutAmine in sePtic cardiomyopathy with Tissue hypoperfusion: a randomized controlled multi-center trial
Protocol code: 87RI18_0012
Sponsor: Centre Hospitalier Et Universitaire De Limoges (Hospital/Clinic/Other health care facility). Phase: Phase III and phase IV (Integrated). Countries: France (ended).
Therapeutic area(s): Diseases [C] - Bacterial Infections and Mycoses [C01]
Gender: Female, Male. Age: 18-64 years, 65+ years. Enrolment: 136.
Status: Ended. Start date (EU): 2020-09-20. End date (EU): 2025-07-01. Decision date: 2024-10-10. Results received: No. Last updated: 2025-02-04.

Condition(s): sepsis
Product: DOBUTAMINE, GLUCOSE 5% AGUETTANT, solution pour perfusion

Primary endpoint: Evolution of a modified Sequential (Sepsis-Related) Organ Failure Assessment (SOFA) score (no gradation of the neurologic system) between baseline (before randomization) and Day 1, Day 2 and Day 3 after randomization.
Endpoint(s): Biological indices of tissue dysoxia at baseline, 6 h after initiating Dobutamine / placebo, Day 1, Day2, Day3: * Circulating lactate level as a marker of tissue hypoperfusion * Central venous oxygen saturation (ScvO2) as a marker of tissue oxygen extraction, Requirement of organ function supports during ICU stay: * Maximal dose and duration of open-labelled Dobutamine used as rescue therapy * Maximal dose and duration of vasopressor support (Norepinephrine, other) * Duration of invasive mechanical ventilation * Requirement and number of sessions of renal replacement therapy (excluding hemodialysis patient for chronic renal failure at the time of randomization, Hemodynamic status at baseline, 6 h after initiating Dobutamine / placebo, Day 1, Day2, Day3: * Arterial pressure, heart rate *Central venous pressure * Cardiac index and stroke volume measured using echocardiography or using calibrated monitoring systems (e.g., transpulmonary thermodilution), Severe cardiovascular adverse events during ICU stay: * Hypotension related to worsened vasoplegia * Excessive sinus tachycardia > 160 bpm * Supraventricular arrhythmias with ventricular rate > 140 bpm * Ventricular arrhythmias * New-onset acute coronary syndrome * Stroke (ischemic or hemorrhagic), Day-7, ICU, Day-28 and Day-90 all-cause mortality, Number of days free from vasopressor support, invasive mechanical ventilation, renal replacement therapy during ICU stay, Length of ICU and hospital stay, Echocardiography at baseline and on Day 1: LV ejection fraction using the monoplane Simpson method, velocity-time integral of LV outflow tract Doppler (stroke volume), E and A mitral Doppler maximal velocity, systolic (S’) and early diastolic maximal tissue Doppler velocity of mitral ring (E’), S’ measured at the lateral aspect of tricuspid ring and M-mode measurement of tricuspid annular plane systolic excursion (TAPSE), systolic pulmonary artery pressure, ratio of end-diastolic RV/LV areas

Source: https://euclinicaltrials.eu/ctis-public/view/2024-517839-50-00